EU clinical trial 2024-518586-10-00: A Phase 2/3 Randomized Study to Evaluate the Safety, Efficacy, and Optimal Dose of Telisotuzumab Adizutecan in Combination with Osimertinib as First-Line Treatment in Patients with Locally Advanced Unresectable or Metastatic EGFR-Mutated Non-Squamous Non-Small Cell Lung Cancer
Protocol code: M25-287
Sponsor: AbbVie Deutschland GmbH & Co. KG (Pharmaceutical company). Phase: Phase II and Phase III (Integrated). Countries: Italy (ongoing, recruiting), Belgium (ongoing, recruiting), Spain (ongoing, recruiting), Portugal (ongoing, recruiting).
Therapeutic area(s): Diseases [C] - Neoplasms [C04]
Gender: Female, Male. Age: 18-64 years, 65+ years. Enrolment: 50.
Status: Ongoing, recruiting. Start date (EU): 2025-09-18. Decision date: 2025-08-25. Results received: No. Last updated: 2026-04-14.
Decision dates by country: BE: 2025-08-25, IT: 2025-11-04, ES: 2025-11-24, PT: 2025-08-25

Condition(s): Non-Squamous Non-Small Cell Lung Cancer
Product: CARBOPLATIN, CISPLATIN, PEMETREXED, CARBOPLATIN, PEMETREXED, OSIMERTINIB, CISPLATIN, Telisotuzumab adizutecan, OSIMERTINIB, CARBOPLATIN, PEMETREXED

Primary endpoint: Phase 2: Objective response (OR) based on Blinded independent central review (BICR) assessment per RECIST version 1.1, Phase 3: Progression-free survival (PFS) based on BICR assessment per RECIST version 1.1.
Endpoint(s): Phase 2: PFS based on BICR assessment per RECIST version 1.1., Phase 2: Duration of response (DoR) based on BICR assessment per RECIST version 1.1., Phase 2: Disease control rate (DC) based on BICR assessment per RECIST version 1.1., Phase 2: Overall Survival, Phase 3: Overall Survival, Phase 3: OR based on BICR assessment per RECIST version 1.1., Phase 3: DoR based on BICR assessment per RECIST version 1.1., Phase 3: DC based on BICR assessment per RECIST version 1.1., Phase 3: Change from baseline at Week 12 in physical functioning as measured by the EORTC QLQ‑C30, Phase 3: Change from baseline at Week 12 in key lung cancer symptoms as measured by the EORTC QLQ-LC13., Phase 3: Change from baseline at Week 12 in GHS/QoL as measured by the EORTC QLQ-C30.

Source: https://euclinicaltrials.eu/ctis-public/view/2024-518586-10-00